EU clinical trial 2024-515276-12-00: TRAnexamic Acid for Preventing blood loss following a cesarean delivery in women with placenta pREVIA: a multicenter randomised, double blind placebo controlled trial. TRAAPrevia
Protocol code: CHUBX 2018/64
Sponsor: Centre Hospitalier Universitaire De Bordeaux (Hospital/Clinic/Other health care facility). Phase: Therapeutic confirmatory (Phase III). Countries: France (ongoing, recruiting).
Therapeutic area(s): Diseases [C] - Female Urogenital Diseases and Pregnancy Complications [C13]
Gender: Female. Age: 18-64 years. Enrolment: 1380.
Status: Ongoing, recruiting. Start date (EU): 2020-07-01. Decision date: 2024-09-17. Results received: No. Last updated: 2024-09-17.

Condition(s): Postpartum Hemorrhage
Product: TRANEXAMIC ACID, SODIUM CHLORIDE

Primary endpoint: Incidence of red blood cell transfusion between delivery of child and discharge from postpartum hospital stay.
Endpoint(s): Mean gravimetrically estimated blood loss, by measuring the suction volume and swab weight according to Gai et al (estimated blood loss = (weight of materials used + materials not used - weight of all materials before surgery)/1.05 + volume included in the suction container), Calculated blood loss > 1000 mL. Calculated blood loss = estimated blood volume × (preoperative Ht -postoperative Ht)/preoperative Ht (where estimated blood volume = weight (kg) × 85) [32, 135]. Preoperative Ht will be the most recent Ht within one week before delivery. Postoperative Ht will be measured at day 2 postpartum,, Calculated blood loss > 1500 ml, Mean calculated blood loss, Mean shock index, defined by the ratio of heart rate to systolic blood pressure, measured at 15, 30, 45, 60 and 120 minutes after birth, or if PPH occurs, Supplementary uterotonic treatment, Iron sucrose perfusion until discharge, Number of red blood cell units transfused between delivery of child and discharge from postpartum hospital stay., Proportion of women transfused between delivery of child and 24 hours postpartum, Arterial embolisation or emergency surgery for PPH, Maternal postpartum transfer to a higher level of care, Proportion of breastfeeding at hospital discharge, Maternal death for any cause, Mean change in peripartum hemoglobin (difference between the most recent Hb within 7 days before delivery and at day 2 postpartum), Mean change in peripartum hematocrit (difference between the most recent Ht within 7 days before delivery and at day 2 postpartum)., Occurrence of potential mild adverse reactions of TXA for women : nausea, vomiting, phosphenes, dizziness (these events will be identified in the theatre room as well as during the postpartum stay in hospital);, Occurrence of thromboembolic events and other severe unexpected adverse reactions (i.e. incidence of deep vein thrombosis confirmed by radiological exams, pulmonary embolism confirmed by radiological exams, myocardial infarction, seizure, renal failure necessitating dialysis ) - (these events will be assessed up to 12 weeks after the delivery, telephone interview at 12 weeks postpartum), Occurrence of neonatal outcomes: transfer to neonatal ICU., Self-administered questionnaire at day 2 postpartum assessing women’s satisfaction regarding their delivery and their psychological status, Self-administered questionnaire sent by mail at 8 weeks of postpartum, assessing their psychological status

Source: https://euclinicaltrials.eu/ctis-public/view/2024-515276-12-00